EU clinical trial 2025-523937-25-00: A Phase 3, Multicenter, Prospective, Randomized, Double-Masked, Parallel-Group Study of EYP-1901, a Tyrosine Kinase Inhibitor (TKI), Compared to Aflibercept (2 mg) in Participants with Diabetic Macular Edema (DME) (EYP-1901-303)
Protocol code: EYP-1901-303
Sponsor: Eyepoint Inc. (Pharmaceutical company). Phase: Therapeutic confirmatory (Phase III). Countries: Germany (ongoing, recruiting), Poland (ongoing, recruiting), Slovakia (ongoing, recruiting).
Therapeutic area(s): Diseases [C] - Eye Diseases [C11]
Gender: Female, Male. Age: 18-64 years, 65+ years. Enrolment: 52.
Status: Ongoing, recruiting. Start date (EU): 2026-05-06. Decision date: 2026-04-07. Results received: No. Last updated: 2026-06-15.
Decision dates by country: PL: 2026-04-07, DE: 2026-04-08, SK: 2026-04-09

Condition(s): Diabetic Macular Edema (DME)
Product: EYP-1901, Eylea 40 mg/mL solution for injection in pre-filled syringe

Primary endpoint: The primary endpoint (or outcome) of this study is to find out whether EYP-1901 can produce the same vision benefits as aflibercept over 56 weeks.
Endpoint(s): The secondary endpoints (or outcomes) of the study are to find out: • How often injections are needed over the 56 weeks of treatment, • Changes in the thickness of the retina (light-sensitive membrane at the back of the eye) from the first treatment over time, • The percentage of participants who maintain, gain, or lose a certain number of letters on an eye chart over time, • The percentage of participants who need additional aflibercept injections up to 88 weeks, • The total number of additional aflibercept injections needed by Week 88, • The percentage of participants whose DME improves over time and also how quickly DME improves over time

Source: https://euclinicaltrials.eu/ctis-public/view/2025-523937-25-00